EU clinical trial 2026-525282-50-00: A Phase 1b-2, Multicenter, Trial to Evaluate the Efficacy, Safety, Pharmacokinetics, and Pharmacodynamics of REC-4881 in Patients with Familial Adenomatous Polyposis (FAP)
Protocol code: REC-4881-201
Sponsor: Recursion Pharmaceuticals Inc. (Pharmaceutical company). Phase: Therapeutic exploratory (Phase II). Countries: Netherlands (authorised, recruitment pending), Germany (authorised, recruitment pending), Spain (authorised, recruitment pending).
Therapeutic area(s): Diseases [C] - Neoplasms [C04]; Diseases [C] - Digestive System Diseases [C06]
Gender: Female, Male. Age: 18-64 years, 65+ years. Enrolment: 20.
Status: Authorised, recruitment pending. Decision date: 2026-07-13. Results received: No. Last updated: 2026-07-15.
Decision dates by country: ES: 2026-07-15, DE: 2026-07-13, NL: 2026-07-13

Condition(s): Familial Adenomatous Polyposis
Product: REC-4881, The placebo is formulated from inactive components of the REC-4881 4 mg capsules include: mannitol, microcrystalline cellulose,hydroxypropyl cellulose, croscarmellose sodium, and magnesium stearate.

Primary endpoint: Part 1: Plasma PK parameters as appropriate, including but not limited to maximum (peak) plasma drug concentration (Cmax), time to reach maximum (peak) plasma concentration following drug administration (Tmax), and area under the plasma concentration-time curve (AUC)., Part 2: •Treatment emergent adverse events and DLTs •Serious adverse events •Treatment discontinuation and dose modification due to toxicity •Percent change from baseline in polyp burden after 12 weeks, 25 weeks, and 37 weeks (Interval Dosing regimen only) and EoT
Endpoint(s): Part 1: •Treatment emergent adverse events •Serious adverse events •Treatment discontinuation and dose modification due to toxicity, Part2: •PK parameters including but not limited to: Cmax, Tmax, trough plasma concentrations (Ctrough), and AUCtau Change from baseline in: •Polyp number •Polyp number >5 mm •Highest histological grade •Spigelman Stage Classification for duodenal polyposis •InSiGHT Stage for rectal/pouch polyposis

Source: https://euclinicaltrials.eu/ctis-public/view/2026-525282-50-00